EU clinical trial 2023-508180-72-00: A Global, Multicenter, Randomized, Double-Blinded, Placebo-Controlled, Phase 2 Study to Evaluate the Safety, Tolerability, and Efficacy of Efgartigimod PH20 SC Administered by a Prefilled Syringe in Kidney Transplant Recipients with Antibody Mediated Rejection.
Protocol code: ARGX-113-2302
Sponsor: Argenx (Pharmaceutical company). Phase: Therapeutic exploratory (Phase II). Countries: Czechia (ongoing, recruitment ended), Spain (ongoing, recruitment ended), Belgium (ongoing, recruitment ended), Germany (ongoing, recruitment ended), France (ongoing, recruitment ended), Austria (ongoing, recruitment ended).
Therapeutic area(s): Diseases [C] - Immune System Diseases [C20]
Gender: Female, Male. Age: 18-64 years, 65+ years. Enrolment: 25.
Status: Ongoing, recruitment ended. Start date (EU): 2024-12-11. Decision date: 2024-10-14. Results received: No. Last updated: 2025-12-10.
Decision dates by country: AT: 2024-10-15, BE: 2024-10-14, CZ: 2024-10-17, DE: 2024-10-17, FR: 2024-10-17, ES: 2024-10-17

Condition(s): Antibody-Mediated Rejection
Product: Placebo PH20 SC – prefilled syringe (placebo to Efgartigimod PH20 SC – prefilled syringe), Efgartigimod

Primary endpoint: Incidence and severity of Adverse Events (AEs), Percentage of participants with permanent treatment discontinuation due to AEs, Laboratory assessments, vital sign measurements, and ECG
Endpoint(s): eGFR (absolute values and changes from baseline [slope]), Histologic changes in kidney biopsy, Urine Protein Creatinine Ratio, Graft and participant survival, Percentage change from baseline in total IgG levels in serum over time, Efgartigimod serum concentration over time and PK parameter Ctrough, Incidence and prevalence of antidrug antibody(ies) (ADA) against efgartigimod in serum over time, Incidence and prevalence of antibodies against rHuPH20 in plasma over time

Source: https://euclinicaltrials.eu/ctis-public/view/2023-508180-72-00